EU clinical trial 2024-510601-29-00: ADAPT: Treatment of Agitated behaviour in patients with Dementia non-responsive to guideline recommended interventions by Argued Personalised Treatment using an N-of-1 approach
Sponsor: Amsterdam UMC (Hospital/Clinic/Other health care facility). Phase: Therapeutic use (Phase IV). Countries: Netherlands (ongoing, recruiting).
Therapeutic area(s): Diseases [C] - Nervous System Diseases [C10]; Analytical, Diagnostic and Therapeutic Techniques and Equipment [E] - Therapeutics [E02]; Psychiatry and Psychology [F] - Behavior and Behavior Mechanisms [F01]
Gender: Female, Male. Age: 65+ years. Enrolment: 100.
Status: Ongoing, recruiting. Start date (EU): 2025-07-23. Decision date: 2025-04-07. Results received: No. Last updated: 2026-03-12.

Condition(s): Dementia, Agitated behaviour
Product: LORAZEPAM, Matching placebo capsules of quetiapine 25mg, olanzapine 2.5mg, and lorazepam 0.5mg will be produced. The placebo capsules will be filled with microcrystalline cellulose ph102 only., QUETIAPINE, OLANZAPINE

Primary endpoint: Agitation over time measured on the Cohen Mansfield Agitation Inventory (CMAI) under psychotropic drug treatment (quetiapine, olanzapine or lorazepam) compared to placebo treatment.
Endpoint(s): Agitation over time measured on the Clinical Global Impression of Severity (CGI-S) and the Clinical Global Impression of Change (CGI-C) under psychotropic drug treatment (quetiapine, olanzapine or lorazepam) compared to placebo treatment., Frequency, severity, and burden of targeted agitated behaviour over time under psychotropic drug treatment (quetiapine, olanzapine or lorazepam) compared to placebo treatment., The incidence and severity of side effects under psychotropic drug treatment (quetiapine, olanzapine or lorazepam) compared to placebo treatment.

Source: https://euclinicaltrials.eu/ctis-public/view/2024-510601-29-00